EU clinical trial 2025-522053-18-00: Developing a first-void urine-based infection model to study HPV-specific antibody-virion interaction before and after vaccination with the Gardasil-9 HPV vaccine – a non-randomized open-label study.
Protocol code: URVIVE
Sponsor: University Of Antwerp (Educational Institution). Phase: Therapeutic exploratory (Phase II). Countries: Belgium (ongoing, recruiting).
Therapeutic area(s): Diseases [C] - Virus Diseases [C02]; Phenomena and Processes [G] - Immune System Phenomena [G13]
Gender: Female. Age: 18-64 years. Enrolment: 50.
Status: Ongoing, recruiting. Start date (EU): 2026-03-25. Decision date: 2025-08-08. Results received: No. Last updated: 2025-10-06.

Condition(s): Human Papillomavirus infection
Product: Gardasil 9 suspension for injection in a pre-filled syringe. Human Papillomavirus 9-valent Vaccine (Recombinant, adsorbed)

Primary endpoint: Detection of HPV16 E1^E4 spliced mRNA in HaCaT keratinocytes after infection with virions isolated from first-void urine samples before and after Gardasil-9TM vaccination.
Endpoint(s): Detection of HPV 6/11/16/18/31/33/45/52/58 specific antibodies in first-void urine and serum samples before and after one or two doses of the Gardasil-9TM vaccine., Detection of HPV 6/11/16/18/26/31/33/35/39/40/42/43/44/45/51/52/54/56/58/59/61/66/68/59/61/66/68/69/70/73/82 DNA in first-void urine samples.

Source: https://euclinicaltrials.eu/ctis-public/view/2025-522053-18-00